EU clinical trial 2023-504425-39-00: C5241009 - An interventional, Phase 1b, randomized, double-blind, sponsor-open, placebo-controlled, multi-center, dose-finding study to evaluate safety, tolerability and pharmacokinetics of sisunatovir in pediatric participants up to age 60 months with Respiratory Syncytial Virus (RSV) Lower Respiratory Tract Infection (LRTI)
Protocol code: C5241009
Sponsor: Pfizer Inc. (Pharmaceutical company). Phase: Human Pharmacology (Phase I)- Other. Countries: Spain (not authorised), Poland (not authorised).
Therapeutic area(s): Diseases [C] - Respiratory Tract Diseases [C08]
Gender: Female, Male. Age: 0-17 years. Enrolment: 16.
Status: Not authorised. Decision date: 2023-11-06. Results received: Yes. Last updated: 2023-11-06.
Decision dates by country: ES: 2023-11-06, PL: 2023-11-06

Condition(s): Respiratory Syncytial Virus (RSV) Infection
Product: Placebo for sisunatovir 50 mg capsule, Sisunatovir

Primary endpoint: Incidence of TEAEs, Incidence of AEs and SAEs leading to discontinuations, Incidence of clinically significant abnormal laboratory values, ECG parameters and vital signs
Endpoint(s): Plasma concentrations of sisunatovir at steady state (Day 3 or later)

Source: https://euclinicaltrials.eu/ctis-public/view/2023-504425-39-00